EU clinical trial 2023-508430-34-00: A randomised, double-blind, placebo-controlled trial to assess the efficacy and safety of FE 999049 for treatment of men with idiopathic infertility
Sponsor: Ferring Pharmaceuticals A/S (Pharmaceutical company). Phase: Therapeutic exploratory (Phase II). Countries: Spain (ended), Sweden (ended), Denmark (ended), Belgium (ended), Germany (ended), Italy (ended).
Therapeutic area(s): Diseases [C] - Male Urogenital Diseases [C12]
Gender: Male. Age: 18-64 years. Enrolment: 197.
Status: Ended. Start date (EU): 2023-01-12. End date (EU): 2024-10-23. Decision date: 2023-11-17. Results received: Yes. Last updated: 2024-10-16.
Decision dates by country: BE: 2023-11-21, IT: 2023-12-04, DE: 2023-11-22, DK: 2023-11-20, ES: 2023-11-17, SE: 2023-11-20

Condition(s): Idiopathic male infertility (including oligoasthenozoospermia).
Product: REKOVELLE 72 micrograms/2.16 mL solution for injection in a pre-filled pen, Pre-filled pen containing 2.16mL solution, subcutaneous injection

Primary endpoint: Spontaneous pregnancy observed in female partner within 9 months after randomisation of male subject, where spontaneous pregnancy is defined as vital pregnancy (documentation of at least one intrauterine gestational sac with fetal heartbeat by ultrasound)

Source: https://euclinicaltrials.eu/ctis-public/view/2023-508430-34-00